EU clinical trial 2025-523646-27-00: Accuracy for Imaging Cardiac Sarcoidosis with 68Ga-Pentixafor Positron Emission Tomography/Computed Tomography (68Ga-Pentixafor PET/CT): ASPECT study
Protocol code: ASPECT-001
Sponsor: Erasmus Universitair Medisch Centrum Rotterdam (Erasmus MC) (Hospital/Clinic/Other health care facility). Phase: Therapeutic exploratory (Phase II). Countries: Netherlands (authorised, recruitment pending).
Therapeutic area(s): Analytical, Diagnostic and Therapeutic Techniques and Equipment [E] - Diagnosis [E01]; Diseases [C] - Cardiovascular Diseases [C14]
Gender: Female, Male. Age: 18-64 years, 65+ years. Enrolment: 20.
Status: Authorised, recruitment pending. Decision date: 2026-02-12. Results received: No. Last updated: 2026-06-18.

Condition(s): Cardiac Sarcoidosis
Product: [68Ga]Ga-PentixaFor

Primary endpoint: Sensitivity and specificity of 68Ga-Pentixafor PET/CT in patients with (suspected) cardiac sarcoidosis. Standard of care 18F-FDG PET/CT is the reference test.
Endpoint(s): The amount of 68Ga-Pentixafor uptake in the myocardium is scored by the Qualification Visual Score for Hypermetabolism (QVSH) o 0 = None (no or less uptake than in the mediastinum) o 1 = Mild (more uptake than in the mediastinum, less than in the liver) o 2 = Moderate (more uptake than in the liver) o 3 = Severe (intense uptake), In case of abnormal uptake the pattern (focal, focal on diffuse or diffuse), extent, and exact location(s) of uptake is described for the left and right ventricle(19). Scoring for the uptake pattern is as follows: o 1 = No uptake o 2 = Diffuse uptake o 3 = Focal uptake o 4 = Focal on diffuse uptake If the uptake in the myocardium is focal or focal on diffuse, the location is scored according to a validated LV segmental scoring system(20)., The standardized uptake values (SUV) is scored for quantitative assessment of tracer uptake(19)., Myocardial suppression will be scored as: • Fully suppressed (no uptake) • Low (more than mediastinal, less than liver) • Intermediate (more than liver uptake) • High focal (much more than liver, focal) • High diffuse (much more than liver, diffuse), Two experienced observers will analyze the images, and findings will be compared., Presence of uptake in other organs suspected for sarcoidosis will be scored, including information on the affected organ., Time-activity curves will be used to study perfusion characteristics of the tracer.

Source: https://euclinicaltrials.eu/ctis-public/view/2025-523646-27-00